EU clinical trial 2024-513948-28-00: Thoracic Radiotherapy plus Durvalumab in Elderly and/or frail NSCLC stage III patients unfit for chemotherapy - Employing optimized (hypofractionated) radiotherapy to foster durvalumab efficacy
Protocol code: TRADE-hypo
Sponsor: Frankfurter Institut Fuer Klinische Krebsforschung IKF GmbH (Pharmaceutical company). Phase: Therapeutic exploratory (Phase II). Countries: Germany (ended).
Therapeutic area(s): Diseases [C] - Respiratory Tract Diseases [C08]
Gender: Female, Male. Age: 18-64 years, 65+ years. Enrolment: 57.
Status: Ended. Start date (EU): 2020-05-08. End date (EU): 2026-01-21. Decision date: 2024-08-15. Results received: No. Last updated: 2025-11-19.

Condition(s): unresectable stage III NSCLC (Non–small-cell lung cancer)
Product: IMFINZI 50 mg/mL concentrate for solution for infusion.

Primary endpoint: Toxicity, defined by the occurence of treatment-related pneumonitis grade ≥ 3, Primary Efficacy Endpoint: Objective response according to RECIST 1.1 criteria
Endpoint(s): Occurence of treatment-related AEs and SAEs according to CTCAE V5.0, Abnormal values of laboratory parameters, PFS according to RECIST 1.1, Duration of Clinical Benefit (Duration of CR, PR, SD) according to RECIST 1.1, MFS, OS, QoL (FACT-L), Descriptive sub-group analyses of efficacy in relation to PD-L1 expression levels (<°1% vs ≥°1%)

Source: https://euclinicaltrials.eu/ctis-public/view/2024-513948-28-00